EU clinical trial 2023-504678-39-00: A multi-center, randomized, placebo- and active-controlled, parallel-group, 24-week proof of concept and dose-finding study to evaluate efficacy, safety, and tolerability of XXB750 in patients with heart failure
Protocol code: CXXB750A12201
Sponsor: Novartis Pharma AG (Pharmaceutical company). Phase: Therapeutic exploratory (Phase II). Countries: Netherlands (ended), Italy (ended), Bulgaria (ended), Spain (ended), Denmark (ended), Portugal (ended), Slovakia (ended), France (ended), Germany (ended), Czechia (ended), Hungary (ended).
Therapeutic area(s): Diseases [C] - Cardiovascular Diseases [C14]
Gender: Female, Male. Age: 18-64 years, 65+ years. Enrolment: 424.
Status: Ended. Start date (EU): 2024-03-13. End date (EU): 2024-11-08. End date: 2024-11-09. Decision date: 2024-03-04. Results received: Yes. Last updated: 2024-11-08.
Decision dates by country: IT: 2024-03-11, PT: 2024-03-06, NL: 2024-03-06, CZ: 2024-06-13, HU: 2024-07-10, DK: 2024-05-31, FR: 2024-03-07, DE: 2024-03-05, SK: 2024-03-04, ES: 2024-03-05, BG: 2024-03-11

Condition(s): Heart Failure
Product: LISINOPRIL, XXB750, AZILSARTAN MEDOXOMIL, CANDESARTAN, BENAZEPRIL, TRANDOLAPRIL, FOSINOPRIL, PERINDOPRIL, MOEXIPRIL, QUINAPRIL, CAPTOPRIL, EPROSARTAN, RAMIPRIL, IRBESARTAN, VALSARTAN AND SACUBITRIL, ZOFENOPRIL, CILAZAPRIL, DELAPRIL, OLMESARTAN MEDOXOMIL, IMIDAPRIL, 0 mg/1 mL Placebo to XXB750 150 mg/1 mL concentrate for solution for injection, ENALAPRIL, TELMISARTAN, VALSARTAN, LOSARTAN

Primary endpoint: Change in log NT-proBNP from baseline to Week 16
Endpoint(s): Change in log NT-proBNP from baseline to Week 16, Adverse events, safety laboratory parameters, and vital signs from baseline to end of study (EOS)

Source: https://euclinicaltrials.eu/ctis-public/view/2023-504678-39-00